EU clinical trial 2025-523971-46-00: A single-arm, open-label, multi-centre, phase I/II first-in-human study evaluating the safety and clinical activity of QEL-005, an autologous CAR T-regulatory cell therapy treatment targeting CD19, in patients with diffuse cutaneous systemic sclerosis (dcSSc) and in patients with difficult to treat rheumatoid arthritis (D2TRA).
Protocol code: QEL-005-CLN-01
Sponsor: Quell Therapeutics Limited (Pharmaceutical company). Phase: Phase I and Phase II (Integrated)- First administration to humans. Countries: Spain (authorised, recruitment pending), Germany (authorised, recruitment pending).
Therapeutic area(s): Diseases [C] - Musculoskeletal Diseases [C05]
Gender: Female, Male. Age: 18-64 years, 65+ years. Enrolment: 8.
Status: Authorised, recruitment pending. Decision date: 2026-04-21. Results received: No. Last updated: 2026-04-30.
Decision dates by country: ES: 2026-04-22, DE: 2026-04-21

Condition(s): Diffuse cutaneous systemic sclerosis (dcSSc) Difficult to treat rheumatoid arthritis (D2TRA)
Product: QEL-005

Primary endpoint: Dose escalation part: Incidence of protocol-defined dose-limiting toxicities (DLTs) within 14 days postinfusion; Treatment-emergent SAEs, adverse events (AEs) and AEs of Special Interest (AESIs); Clinically significant changes in safety laboratory assessments, ECG and vital signs., Expansion part: Treatment-emergent serious adverse events (SAEs), adverse events (AEs) and AEs of Special Interest (AESIs); Clinically significant changes in safety laboratory assessments, electrocardiogram (ECG) and vital signs.

Source: https://euclinicaltrials.eu/ctis-public/view/2025-523971-46-00